EU clinical trial 2023-503226-39-00: Study of immunological activity after personalized immunomodulatory therapy regulating the Th17 pathway in patients with extramembranous glomerulonephritis
Protocol code: 22-AOIP-03
Sponsor: Centre Hospitalier Universitaire De Nice (Hospital/Clinic/Other health care facility). Phase: Therapeutic exploratory (Phase II). Countries: France (ended).
Therapeutic area(s): Not possible to specify
Gender: Female, Male. Age: 18-64 years, 65+ years. Enrolment: 5.
Status: Ended. Start date (EU): 2023-07-18. End date (EU): 2025-09-14. Decision date: 2023-06-08. Results received: No. Last updated: 2024-07-22.

Condition(s): Extramembranous glomerulonephritis
Product: Pegasys 180 micrograms solution for injection in pre-filled syringe

Primary endpoint: Intraindividual variation in anti-PLA2R1 antibody titer (ELISA titer in RU/mL), after 6 months of IFNα (Pegasys®) treatment compared to pre-treatment antibody titer
Endpoint(s): Intraindividual variation in proteinuria and albumin levels under IFNα (Pegasys®) treatment and stable symptomatic treatment, Intraindividual variation in cytokine profile (assay of 9 cytokines: IL-12p70; IL-17A; IL-4; IL-5; IL-1β; IL-10; IFNα; IL-6 and IFNγ) before and after 6 months of personalized treatment with IFNα (Pegasys®), Clinical and Biological Tolerance of IFNα Therapy (Pegasys®), Description of an effective IFNα (Pegasys®) regimen (one or two monthly doses) to induce an IL-17A level below 73 pg/ml

Source: https://euclinicaltrials.eu/ctis-public/view/2023-503226-39-00